EU clinical trial 2024-514795-41-00: Rebound pain after volar plate surgery in infraclavicular brachial plexus block with ropivacaine 3.75 mg/ml compared with 7.5 mg/ml. A prospective, triple blinded randomised controlled trial
Sponsor: Oslo University Hospital HF (Hospital/Clinic/Other health care facility). Phase: Therapeutic use (Phase IV). Countries: Norway (ended).
Therapeutic area(s): Analytical, Diagnostic and Therapeutic Techniques and Equipment [E] - Anesthesia and Analgesia [E03]
Gender: Female, Male. Age: 18-64 years, 65+ years. Enrolment: 80.
Status: Ended. Start date (EU): 2025-02-14. End date (EU): 2026-04-08. Decision date: 2025-01-15. Results received: No. Last updated: 2025-09-25.

Condition(s): Radius fracture
Product: ARCOXIA 120 mg filmdrasjerte tabletter, OxyNorm 10 mg/ml injeksjonsvæske/infusjonsvæske, oppløsning, Paracet 500 mg tabletter, Oxycodone Actavis 5 mg harde kapsler, ARCOXIA 90 mg filmdrasjerte tabletter, Paracet 1 g tabletter, OxyContin 10 mg depottabletter, Dexamethasone Orifarm 4 mg tabletter, Ropivacain Fresenius Kabi 7,5 mg/ml injeksjonsvæske, oppløsning

Primary endpoint: Worst pain score during the first 48 hours after surgery, as measured by Verbal Numeric Rating Score (VNRS) 0-10
Endpoint(s): Rebound pain, defined as VNRS (0-10) equal or above 7 at block resolution, Difference in VNRS and Likert scale in the post anesthesia care unit (PACU) 8 hours, 24 hours, 48 hours, 3 days and 7 days after surgery., Duration of moderate pain (VNRS 4 or above) and strong pain (VNRS 7 or above)., Average and worst pain score (VNRS) 8-24 hours, 24-48 hours, last 24 hours at 3 days and 7 days after surgery., Pain at rest and with movement at 6 weeks after surgery (VNRS 0-10 and Likert scale), Worst pain last week at 6 weeks after surgery and average pain last 24 hours at 6 weeks after surgery., Total opioid and analgesic consumption first 24 hours, 24-48 hours, 48 hours to 1 week and last week at 6 weeks after surgery., Duration of motoric and sensoric block from peripheral nerve block (needle out)., Time from needle out to first rescue analgesic, Quality of sleep, work ability, social life and cognitive function the first night, 48 hours, 3 days, 7 days and 6 weeks after surgery (Likert scale)., Number of patients answering yes to the question: Do you have bothersome pain?, The type of pain experienced 6 weeks after surgery, if persistens pain (heat, cold, burning, prickly, tingling, itchy, squeezing)., Satisfaction with pain treatment (yes/no), Sensory and motor test of adequate nerves after peripheral nerve block before surgery and 1 hour after surgery., Was the nerve block adequate for surgery (yes/no)

Source: https://euclinicaltrials.eu/ctis-public/view/2024-514795-41-00